EU clinical trial 2024-517065-16-00: A Phase 2, single arm study on dacarbazine (DTIC) followed by immunotherapy re-challenge in unresectable or metastatic melanoma with primary resistance to PD-1/PD-L1 or PD-1 + CTLA-4 blockade (PROMIT: PReconditioning of TumOr, Tumor Microenvironment and the Immune System to ImmunoTherapy)
Protocol code: PROMIT
Sponsor: Universitaetsklinikum Erlangen AöR (Hospital/Clinic/Other health care facility). Phase: Therapeutic exploratory (Phase II). Countries: Germany (ended).
Therapeutic area(s): Diseases [C] - Neoplasms [C04]
Gender: Female, Male. Age: 18-64 years, 65+ years. Enrolment: 45.
Status: Ended. Start date (EU): 2020-01-13. End date (EU): 2026-01-15. Decision date: 2024-11-14. Results received: Yes. Last updated: 2024-11-14.

Condition(s): Melanoma
Product: PEMBROLIZUMAB, NIVOLUMAB, IPILIMUMAB, DACARBAZINE

Primary endpoint: Overall response rate (ORR) at week 14 according to RECIST 1.1 in all patients receiving at least on. A patient is defined as responder if a complete response (CR) or partial response (PR) can be seen. A patient with stable disease (SD) or progressive disease (PD) will be defined as non-responder., Overall survival (OS), defined as the time between study inclusion and date of death (any cause).
Endpoint(s): Collect biological samples (tissue/blood/stool) to assess immunological changes, Quality of life assessed by EORTC QLQ-C30

Source: https://euclinicaltrials.eu/ctis-public/view/2024-517065-16-00